EU clinical trial 2022-501957-35-00: Contribution of an antiviral drug (Valaciclovir) in the treatment of generalized periodontitis (stage III or IV and grade A, B or C): prospective, randomized and double blind clinical trial.
Protocol code: 20-API-02
Sponsor: Centre Hospitalier Universitaire De Nice (Hospital/Clinic/Other health care facility). Phase: Therapeutic confirmatory (Phase III). Countries: France (ongoing, recruiting).
Therapeutic area(s): Diseases [C] - Virus Diseases [C02]; Diseases [C] - Skin and Connective Tissue Diseases [C17]
Gender: Female, Male. Age: 18-64 years, 65+ years. Enrolment: 142.
Status: Ongoing, recruiting. Start date (EU): 2023-12-12. Decision date: 2023-05-26. Results received: No. Last updated: 2026-06-03.

Condition(s): Generalized periodontitis (stage III or IV and grade A, B or C)
Product: CELLULOSE, MICROCRYSTALLINE, Valaciclovir Mylan 500 mg, filmomhulde tabletten

Primary endpoint: Efficacy will be assessed by measuring the periodontal bag depth at counding, unisng a graduated (in millimeter) and coloured probe used at low pressure (<0.2N) at visit 3
Endpoint(s): Conventional periodontal clinical indices are the Bleeding on Probing (BOP), the plaque index (PI), the Clinical Attachement Level (CAL) and the pocket depth at sounding. These indices will be collected from the same tooth that was determined for the primary objective, The EBV, CMV and HSV1 viruses levels in periodontal sample is measured through quantitative PCR of their viral genomes (DNA)., The twenty bacterial species level in periodontal sample is measured through quantitative PCR of the bacterial genomes (DNA)., Surgery is available from visit 3 (during periodontal re-evaluation) and is indicated for patient with a good degree of hygiene (IP≤ 20%) but with persistent pockets (PPS > 5mm) and bleeding at sounding., The oral health impact on quality of life score is based on the Oral Health Impact Profile 14 (OHIP-14) questionnaire, which measures the impact of oral conditions on the well-being and quality of life of the patient., The medico-economic impact is evaluated by the incremental cost-effectiveness ratio by relating the difference in the cost of each strategy to the difference in efficiency (number of patients who had therapeutic surgery during the follow-up period).

Source: https://euclinicaltrials.eu/ctis-public/view/2022-501957-35-00